EU clinical trial 2022-500395-57-00: A Phase 3, Randomized, Double-blind, Placebo-controlled Study to Evaluate Pembrolizumab Versus Placebo as Adjuvant Therapy Following Surgery and Radiation in Participants with High-risk Locally Advanced Cutaneous Squamous Cell Carcinoma (LA cSCC) (KEYNOTE-630).
Protocol code: MK-3475-630
Sponsor: Merck Sharp & Dohme Corp. (Pharmaceutical company). Phase: Therapeutic confirmatory (Phase III). Countries: Germany (ended), France (ended), Spain (ended), Italy (ended), Norway (ended), Portugal (ended), Ireland (ended), Poland (ended), Hungary (ended), Greece (ended), Romania (ended).
Therapeutic area(s): Diseases [C] - Neoplasms [C04]
Gender: Female, Male. Age: 18-64 years, 65+ years. Enrolment: 267.
Status: Ended. Start date (EU): 2019-03-04. End date (EU): 2026-01-20. End date: 2026-01-21. Decision date: 2023-01-18. Results received: No. Last updated: 2026-02-24.
Decision dates by country: RO: 2023-03-03, IT: 2023-01-20, ES: 2023-01-19, PL: 2023-01-24, NO: 2023-01-23, HU: 2023-01-18, FR: 2023-01-26, IE: 2023-01-18, DE: 2023-01-26, PT: 2023-01-19, GR: 2023-01-23

Condition(s): Resectable high-risk Locally Advanced Cutaneous Squamous Cell Carcinoma (LA cSCC)
Product: Placebo to keytruda - Normal saline solution, KEYTRUDA 25 mg/mL concentrate for solution for infusion

Primary endpoint: Recurrence-Free Survival (RFS) as Assessed by the Investigator and Confirmed by Biopsy
Endpoint(s): Overall Survival (OS), Change From Baseline in the European Organisation for Research and Treatment of Cancer (EORTC) Quality of Life Questionnaire Core 30 (EORTC QLQ-C30) Score, Change From Baseline in Physical Functioning Using the European Organisation for Research and Treatment of Cancer Quality of Life Questionnaire Core 30 (EORTC QLQ-C30) Items 1-5 Score, Percentage of Participants Who Experience an Adverse Event (AE), Percentage of Participants Who Discontinue Study Treatment Due to an Adverse Event (AE)

Source: https://euclinicaltrials.eu/ctis-public/view/2022-500395-57-00